EU clinical trial 2022-502912-35-00: Vaccination against human papillomavirus (HPV) after allogeneic stem cell transplantation, a randomized study between early and late vaccination.
Protocol code: ALLO-HPV
Sponsor: Vastra Gotalandsregionen (Hospital/Clinic/Other health care facility). Phase: Therapeutic exploratory (Phase II). Countries: Sweden (ongoing, recruiting).
Therapeutic area(s): Diseases [C] - Neoplasms [C04]; Diseases [C] - Virus Diseases [C02]
Gender: Female, Male. Age: 18-64 years. Enrolment: 100.
Status: Ongoing, recruiting. Start date (EU): 2025-03-12. Decision date: 2024-07-19. Results received: No. Last updated: 2026-04-23.

Condition(s): Recipients of allogeneic stem cell transplantation
Product: Gardasil 9 suspension for injection. Human Papillomavirus 9-valent Vaccine (Recombinant, adsorbed)

Primary endpoint: Antibody level (GMT) against HPV 16 measured 1 months after the third vaccine dose, early vs late
Endpoint(s): Antibody level (GMT) against all 9 HPV-serotypes included in vaccine (-6, -11, -16, -18, -31, -33, -45, -52, -58) measured 1 month after the third vaccinedose. Early vs late., Antibody level (GMT) against all 9 HPV-serotypes included in vaccine (-6, -11, -16, -18, -31, -33, -45, -52, -58) measured at 12 months after the third vaccine dose. Early vs late., Proportion seropositive/negative against 9 HPV-serotypes included in vaccine measured 1 and 12 months after third dose. Early vs late., Seroconversion against 9 HPV-serotypes included in vaccine, prevaccination compared to 1 month after third dose, early vs late., Proportion seropositive against 7/9 HPV-types included in the vaccine at 1 and 12 months after completion of vaccination. Early vs late.

Source: https://euclinicaltrials.eu/ctis-public/view/2022-502912-35-00